EU clinical trial 2025-522748-42-00: A Phase 3, Randomized, Open-Label Study of INCB123667 Versus Investigator's Choice of Chemotherapy in Participants With Platinum Resistant Ovarian Cancer With Cyclin E1 Overexpression (MAESTRA 2)
Protocol code: INCB123667-305
Sponsor: Incyte Corp. (Pharmaceutical company). Phase: Therapeutic confirmatory (Phase III). Countries: Ireland (authorised, recruitment pending), Poland (authorised, recruitment pending), France (authorised, recruitment pending), Netherlands (authorised, recruiting), Spain (authorised, recruitment pending), Italy (authorised, recruitment pending), Germany (authorised, recruitment pending), Belgium (authorised, recruitment pending).
Therapeutic area(s): Diseases [C] - Neoplasms [C04]
Gender: Female. Age: 18-64 years, 65+ years. Enrolment: 308.
Start date (EU): 2026-07-10. Decision date: 2026-04-17. Results received: No. Last updated: 2026-07-29.
Decision dates by country: FR: 2026-04-20, DE: 2026-04-20, NL: 2026-04-22, IE: 2026-05-15, PL: 2026-04-23, ES: 2026-04-21, IT: 2026-04-17, BE: 2026-04-17

Condition(s): Ovarian cancer
Product: Caelyx pegylated liposomal 2 mg/ml concentrate for solution for infusion, PACLITAXEL, GEMCITABINE HYDROCHLORIDE, TOPOTECAN HYDROCHLORIDE

Primary endpoint: 1. PFS by BICR, defined as the time from the date of randomization until the earliest date of disease progression as determined by BICR per RECIST v1.1, or death due to any cause, whichever occurs first, 2. OS, defined as the time from the date of randomization until death due to any cause.
Endpoint(s): Key Secondary 1. Objective response by BICR, defined as having a best overall response of CR or PR, as determined by BICR per RECIST v1.1., Secondary 2. DOR by BICR, defined as the time from the earliest date of CR or PR until the earliest date of disease progression, as determined by BICR per RECIST v1.1, or death due to any cause, whichever occurs first., Secondary 3. PFS by investigator, defined as the time from the date of randomization until the earliest date of disease progression, as determined by investigator assessment per RECIST v1.1, or death due to any cause, whichever occurs first., Secondary 4. Objective response by investigator, defined as having a best overall response of CR or PR, as determined by investigator assessment per RECIST v1.1., Secondary 5. DOR by investigator, defined as the time from the earliest date of CR or PR until the earliest date of disease progression, as determined by investigator assessment per RECIST v1.1, or death due to any cause, whichever occurs first., Secondary 6. AEs, assessed by physical examinations, evaluating changes in vital signs and ECGs, and through clinical laboratory blood sample evaluations., Secondary 7. Treatment interruptions, dose reductions, and discontinuation of study treatment due to AEs., Secondary 8. HRQoL, assessed by changes from baseline in EORTC QLQ-C30, EORTC QLQ-OV28, and EQ-5D-5L questionnaire scores

Source: https://euclinicaltrials.eu/ctis-public/view/2025-522748-42-00